EU clinical trial 2023-505794-32-04: Multifactorial intervention to reduce cardiovascular disease in type 1 diabetes
Sponsor: Steno Diabetes Center Copenhagen (Hospital/Clinic/Other health care facility). Phase: Therapeutic confirmatory (Phase III). Countries: Denmark (ongoing, recruiting).
Therapeutic area(s): Diseases [C] - Hormonal diseases [C19]; Diseases [C] - Cardiovascular Diseases [C14]
Gender: Female, Male. Age: 18-64 years, 65+ years. Enrolment: 2000.
Status: Ongoing, recruiting. Start date (EU): 2024-07-05. Decision date: 2024-05-13. Results received: No. Last updated: 2026-06-24.

Condition(s): Type 1 diabetes
Product: SOTAGLIFLOZIN, Ozempic 1 mg solution for injection in pre-filled pen, Finerenone, BAY 94-8862, Ozempic 0.25 mg solution for injection in pre-filled pen, Ozempic 0.5 mg solution for injection in pre-filled pen, Finerenone

Primary endpoint: • First major adverse cardiovascular events (MACE), and first hospitalization for heart failure (HHF). The primary efficacy analysis will analyse if a multifactorial intervention strategy is superior to standard care with respect to time to first event of the composite endpoint of first non-fatal myocardial infarction, first non-fatal stroke, cardiovascular death or first hospitalization for heart failure five years after inclusion of the first patient.
Endpoint(s): Will determine whether a multifactorial intervention is superior to standard care with respect time to a composite endpoint of renal function (end-stage kidney disease (ESKD) (dialysis, renal death, transplantation) a sustained eGFR <15 ml/min/1.73 m2 or >50% sustained decline in eGFR from baseline) compared to standard of care (sustained means change in eGFR sustained for at least 30 days)., To determine the effect of multifactorial intervention is superior to standard of care with respect to the individual components of the composite endpoints., To determine whether a multifactorial intervention is superior to standard care with respect to all-cause mortality.

Source: https://euclinicaltrials.eu/ctis-public/view/2023-505794-32-04